EU clinical trial 2023-505228-79-00: A Study to Learn How Different Manufactured Products of the Study Medicine Called Sisunatovir are Taken Up Into the Blood When Taken on an Empty Stomach or When Taken With a Meal in Healthy Adults
Sponsor: Pfizer Inc. (Pharmaceutical company). Phase: Human Pharmacology (Phase I)- Other. Countries: Belgium (ended).
Therapeutic area(s): Diseases [C] - Virus Diseases [C02]
Gender: Female, Male. Age: 18-64 years, 65+ years. Enrolment: 24.
Status: Ended. Start date (EU): 2023-08-28. End date (EU): 2024-02-26. End date: 2024-02-27. Decision date: 2023-08-16. Results received: No. Last updated: 2023-12-14.

Condition(s): RSV (Respiratory Syncytial Virus)

Source: https://euclinicaltrials.eu/ctis-public/view/2023-505228-79-00